EU clinical trial 2023-504885-50-00: (20186 - FIONA OLE) An 18-month, open-label, single-arm safety extension study of an age-and bodyweight-adjusted oral finerenone regimen, in addition to an ACEI or ARB, for the treatment of children and young adults from 1 to 18 years of age with chronic kidney disease and proteinuria
Protocol code: 20186
Sponsor: Bayer AG (Pharmaceutical company). Phase: Therapeutic confirmatory (Phase III). Countries: France (ongoing, recruiting), Hungary (ongoing, recruitment ended), Portugal (ongoing, recruitment ended), Austria (ended), Finland (ongoing, recruiting), Denmark (ongoing, recruiting), Poland (ongoing, recruiting), Spain (ongoing, recruiting), Italy (ongoing, recruitment ended), Belgium (ongoing, recruitment ended), Lithuania (ongoing, recruitment ended), Greece (ongoing, recruiting), Sweden (ongoing, recruitment ended), Netherlands (ongoing, recruitment ended), Germany (ongoing, recruitment ended), Czechia (ongoing, recruitment ended), Bulgaria (authorised, recruitment pending).
Therapeutic area(s): Diseases [C] - Nutritional and Metabolic Diseases [C18]
Gender: Female, Male. Age: 0-17 years, 18-64 years. Enrolment: 69.
Start date (EU): 2022-11-07. Decision date: 2024-03-27. Results received: No. Last updated: 2026-06-10.
Decision dates by country: IT: 2024-03-28, DK: 2024-03-27, AT: 2024-05-02, PL: 2024-03-28, FR: 2024-03-28, FI: 2024-03-27, ES: 2024-04-01, CZ: 2024-03-27, PT: 2024-03-27, SE: 2024-03-27, NL: 2024-03-28, DE: 2024-03-27, BE: 2024-04-12, LT: 2024-05-08, BG: 2025-11-25, HU: 2024-04-04, GR: 2024-05-13

Condition(s): Treatment of children with chronic kidney disease and proteinuria
Product: BAY 948862, Finerenone, BAY 94-8862, Finerenone Bayer

Primary endpoint: Number of participants with treatment emergent adverse events (TEAEs), Change in serum potassium levels from baseline to Day 540±7, Change in systolic blood pressure (SBP) from baseline to Day 540±7
Endpoint(s): Change in urinary protein-to-creatinine ratio (UPCR) and urinary albumin-to-creatinine ratio (UACR) from baseline to Day 540±7, Change in estimated glomerular filtration rate (eGFR) from baseline to Day 540±7

Source: https://euclinicaltrials.eu/ctis-public/view/2023-504885-50-00